EU clinical trial 2024-514791-40-00: AcSé-ESMART: European Proof-of-Concept Therapeutic Stratification Trial of Molecular Anomalies in Relapsed or Refractory Tumors
Protocol code: 2016/2369
Sponsor: Institut Gustave Roussy (Hospital/Clinic/Other health care facility). Phase: Phase I and Phase II (Integrated)- Other. Countries: Spain (ongoing, recruiting), Italy (ongoing, recruiting), France (ongoing, recruiting), Netherlands (ongoing, recruiting), Denmark (ongoing, recruiting).
Therapeutic area(s): Diseases [C] - Neoplasms [C04]
Gender: Female, Male. Age: 0-17 years. Enrolment: 398.
Status: Ongoing, recruiting. Start date (EU): 2016-08-03. Decision date: 2024-10-18. Results received: No. Last updated: 2026-02-04.
Decision dates by country: NL: 2024-10-23, DK: 2024-10-21, FR: 2024-10-18, IT: 2024-10-23, ES: 2024-10-21

Condition(s): pediatric cancer
Product: TEMOZOLOMIDE VIATRIS 5 mg, gélule, Capivasertib, TEMOZOLOMIDE VIATRIS 100 mg, gélule, VINORELBINE ACCORD 20 mg, capsule molle, Votubia 3 mg dispersible tablets, Bavencio 20 mg/mL concentrate for solution for infusion, Peposertib, INC280, Enasidenib Mesilate, Futibatinib, TEMOZOLOMIDE VIATRIS 20 mg, gélule, Capivasertib, VINORELBINE ACCORD 30 mg, capsule molle, INC280, Enasidenib Mesilate, Votubia 5 mg dispersible tablets, Votubia 2 mg dispersible tablets, Capivasertib

Primary endpoint: The recommended phase II dose (RP2D) will be defined as the adult recommended dose (adjusted for weight or BSA) if toxicity and PK profiling are similar in children and in adults, or a higher dose, providing it is below or equal to the maximum tolerated dose (MTD).
Endpoint(s): The maximum tolerated dose (MTD) will be defined as the dose associated with or closest to 25% of DLTs in cycle 1., Dose Limiting Toxicities (DLT) will be defined using NCI CTCAE v4.03., Overall response rate (ORR) will be defined as percentage of patients achieving confirmed CR or confirmed PR as per standard methods for the underlying disease., Duration of response (DOR) will be defined as the time period between the first documented response (PR or CR) and the time of first documented progression (clinically or radiologically – Appendix 3 to 7) or death from any cause, whichever comes first. Duration of response for patients free of progression at the cut-off date will be censored at the last assessment date., Progression-free survival (PFS) will be defined as the time from treatment initiation until the date of first documented progression or death from any cause, whichever comes first. Patients alive and free of progression at the cut-off date will be censored at the last assessment date., Overall survival (OS) will be defined as the time from treatment initiation until the date of death from any cause. Patients alive at the cut-off date will be censored at the date of last news., Adverse events according to the NCI CTCAE V4.03 in all cycles of treatment., PK parameters, including but not limited to plasma concentration time profiles, AUClast, AUCtau, Cmin, Cmax, Tmax, Clearance, Half-life time., Relationship between the molecular profile of the tumor samples, circulating tumor DNA and tumor growth.

Source: https://euclinicaltrials.eu/ctis-public/view/2024-514791-40-00